EU clinical trial 2023-509188-26-00: A Study to Evaluate the Safety, Tolerability, Pharmacokinetics, and Pharmacodynamics of Subcutaneously Administered Mosunetuzumab to Participants with Systemic Lupus Erythematosus
Protocol code: GA43191
Sponsor: F. Hoffmann-La Roche AG (Pharmaceutical company). Phase: Human Pharmacology (Phase I)- Other. Countries: Poland (ended).
Therapeutic area(s): Diseases [C] - Immune System Diseases [C20]
Gender: Female, Male. Age: 18-64 years, 65+ years. Enrolment: 7.
Status: Ended. Start date (EU): 2022-10-27. End date (EU): 2024-12-17. End date: 2024-12-18. Decision date: 2024-06-24. Results received: No. Last updated: 2025-02-10.

Condition(s): Systemic Lupus Erythematosus (SLE)

Source: https://euclinicaltrials.eu/ctis-public/view/2023-509188-26-00